EU clinical trial 2026-525521-20-00: The headache- and migraine-inducing effects of pitolisant in women with migraine without aura
Sponsor: Syddansk Universitet (University of Southern Denmark) (Educational Institution). Phase: Phase I and Phase II (Integrated)- Other. Countries: Denmark (authorised, recruitment pending).
Therapeutic area(s): Diseases [C] - Nervous System Diseases [C10]
Gender: Female. Age: 18-64 years. Enrolment: 14.
Status: Authorised, recruitment pending. Decision date: 2026-03-26. Results received: No. Last updated: 2026-03-26.

Condition(s): Migraine without aura
Product: IBUPROFEN, Wakix 18 mg film-coated tablets, SUMATRIPTAN, GELATIN

Primary endpoint: The occurrence of migraine-like attacks in pitolisant- and placebo-treated women with migraine without aura
Endpoint(s): Headache intensity over time, expressed as the area under the curve (AUC), following pitolisant and placebo administration in women with migraine without aura, The occurrence of any headache, irrespective of migraine criteria, following pitolisant and placebo administration

Source: https://euclinicaltrials.eu/ctis-public/view/2026-525521-20-00